EU clinical trial 2024-516972-14-00: Efficacy and safety of Cabozantinib in patients with hepatocellular carcinoma progressing on or intolerant to prior treatment with immune checkpoint inhibitors: A phase II study (Immunocabo)
Sponsor: Humanitas Mirasole S.p.A. (Hospital/Clinic/Other health care facility). Phase: Therapeutic exploratory (Phase II). Countries: Italy (ended).
Therapeutic area(s): Diseases [C] - Neoplasms [C04]
Gender: Female, Male. Age: 18-64 years, 65+ years. Enrolment: 46.
Status: Ended. Start date (EU): 2020-01-30. End date (EU): 2025-06-19. Decision date: 2024-10-28. Results received: No. Last updated: 2024-10-28.

Condition(s): Hepatocellular carcinoma
Product: CABOMETYX 60 mg film-coated tablets, CABOMETYX 20 mg film-coated tablets, CABOMETYX 40 mg film-coated tablets

Primary endpoint: PFS on cabozantinib treatment (considering as PFS events: clinical or radiological progressive disease, per RECIST 1.1, or death).
Endpoint(s): Objective Response Rate (ORR) as per RECIST 1.1, duration of response, Treatment Time Failure (TTF), Time to Progression (TTP), and Overall Survival (OS)., To evaluate the safety and tolerability, according to NCI-CTCAE v.5

Source: https://euclinicaltrials.eu/ctis-public/view/2024-516972-14-00